EU clinical trial 2023-506752-24-00: A Randomized, Double-blind, Placebo-controlled, Phase 3 Study of Pembrolizumab Plus Chemotherapy Versus Placebo Plus Chemotherapy for the Treatment of Chemotherapy-Candidate Hormone Receptor-Positive, Human Epidermal Growth Factor Receptor 2-Negative (HR+/HER2-) Locally Recurrent Inoperable or Metastatic Breast Cancer (KEYNOTE-B49)
Protocol code: MK-3475-B49
Sponsor: Merck Sharp & Dohme LLC (Pharmaceutical company). Phase: Therapeutic confirmatory (Phase III). Countries: Ireland (ongoing, recruitment ended), Hungary (ended), France (ongoing, recruitment ended), Portugal (ongoing, recruitment ended), Sweden (ongoing, recruitment ended), Spain (ongoing, recruitment ended), Germany (ongoing, recruitment ended), Austria (ongoing, recruitment ended), Netherlands (ongoing, recruitment ended), Italy (ongoing, recruitment ended), Romania (ended), Poland (ongoing, recruitment ended), Greece (ongoing, recruitment ended).
Therapeutic area(s): Diseases [C] - Neoplasms [C04]
Gender: Female, Male. Age: 18-64 years, 65+ years. Enrolment: 265.
Start date (EU): 2021-08-05. Decision date: 2023-11-07. Results received: No. Last updated: 2026-06-22.
Decision dates by country: HU: 2023-11-07, RO: 2023-12-08, GR: 2023-12-15, SE: 2023-11-08, IE: 2023-11-07, AT: 2023-11-15, PT: 2023-11-07, DE: 2023-11-10, NL: 2023-11-13, ES: 2023-11-10, FR: 2023-11-07, PL: 2023-12-14, IT: 2023-11-24

Condition(s): Locally recurrent inoperable or metastatic HR+/HER2- breast cancer, which has not been previously treated with cytotoxic chemotherapy in the noncurative setting
Product: DOXORUBICIN, DOXORUBICIN HYDROCHLORIDE, LIPOSOMAL, PACLITAXEL ALBUMIN-BOUND, Placebo to Keytruda - Normal Saline, PACLITAXEL, Placebo to Keytruda - Dextrose, KEYTRUDA 25 mg/mL concentrate for solution for infusion, CAPECITABINE

Primary endpoint: Progression-free survival (PFS) per Response Evaluation Criteria in Solid Tumors 1.1 (RECIST 1.1) by Blinded independent Central Review (BICR) in Participants With Combined Positive Score (CPS) ≥1
Endpoint(s): Overall Survival (OS) in Participants With CPS ≥ 1, PFS per RECIST 1.1 by BICR in Participants With CPS ≥10, Overall Survival (OS) in Participants With CPS ≥ 10, PFS per RECIST 1.1 by Investigator in Participants With CPS ≥10, PFS per RECIST 1.1 by Investigator in Participants With CPS ≥1, Objective Response Rate (ORR) per RECIST 1.1 by BICR in Participants With CPS ≥10, ORR per RECIST 1.1 by BICR in Participants With CPS ≥1, Disease Control Rate (DCR) per RECIST 1.1 by BICR in Participants With CPS ≥10, DCR per RECIST 1.1 by BICR in Participants With CPS ≥1, Duration of Response (DOR) per RECIST 1.1 by BICR in Participants With CPS ≥10, DOR per RECIST 1.1 by BICR in Participants With CPS ≥1, Change From Baseline in Global Health Status/Quality of Life Score on the European Organization for Research and Treatment of Cancer Quality of Life Questionnaire Core 30 (EORTC QLQ-C30) in Participants with CPS ≥10, Change From Baseline in Global Health Status/Quality of Life Score on the EORTC QLQ-C30 in Participants with CPS ≥1, Change From Baseline in Physical Functioning Score on the EORTC QLQ-C30 in Participants with CPS ≥10, Change From Baseline in Physical Functioning Score on the EORTC QLQ-C30 in Participants with CPS ≥1, Change From Baseline in Emotional Functioning Score on the EORTC QLQ-C30 in Participants with CPS ≥10, Change From Baseline in Emotional Functioning Score on the EORTC QLQ-C30 in Participants with CPS ≥1, Change From Baseline in Fatigue Score on the EORTC QLQ-C30 in Participants with CPS ≥10, Change From Baseline in Fatigue Score on the EORTC QLQ-C30 in Participants with CPS ≥1, Change From Baseline in Diarrhea Score on the EORTC QLQ-C30 in Participants with CPS ≥10, Change From Baseline in Diarrhea Score on the EORTC QLQ-C30 in Participants with CPS ≥1, Time to Deterioration (TTD) in Global Health Status/Quality of Life Score on the EORTC QLQ-C30 in Participants with CPS ≥10, TTD in Global Health Status/Quality of Life Score on the EORTC QLQ-C30 in Participants with CPS ≥1, TTD in Physical Functioning Score on the EORTC QLQ-C30 in Participants with CPS ≥10, TTD in Physical Functioning Score on the EORTC QLQ-C30 in Participants with CPS ≥1, TTD in Emotional Functioning Score on the EORTC QLQ-C30 in Participants with CPS ≥10, TTD in Emotional Functioning Score on the EORTC QLQ-C30 in Participants with CPS ≥1, TTD in Fatigue Score on the EORTC QLQ-C30 in Participants with CPS ≥10, TTD in Fatigue Score on the EORTC QLQ-C30 in Participants with CPS ≥1, TTD in Diarrhea Score on the EORTC QLQ-C30 in Participants with CPS ≥10, TTD in Diarrhea Score on the EORTC QLQ-C30 in Participants with CPS ≥1, Percentage of Participants who Experience an Adverse Event (AE), Percentage of Participants who Discontinue Study Drug due to an AE

Source: https://euclinicaltrials.eu/ctis-public/view/2023-506752-24-00